EU clinical trial 2023-510186-98-00: DISTINCT: inDividual, targeted thrombosIS prophylaxis versus the standard ‘one size fits all’ approach in patients undergoing Total hIp or total kNee replaCemenT: a national, multicenter, randomized, multi-arm, open-label trial
Sponsor: Academisch Ziekenhuis Leiden (Hospital/Clinic/Other health care facility). Phase: Therapeutic use (Phase IV). Countries: Netherlands (ongoing, recruiting).
Therapeutic area(s): Diseases [C] - Cardiovascular Diseases [C14]
Gender: Female, Male. Age: 18-64 years, 65+ years. Enrolment: 10078.
Status: Ongoing, recruiting. Start date (EU): 2024-10-23. Decision date: 2024-08-12. Results received: No. Last updated: 2026-03-20.

Condition(s): Venous thromboembolism
Product: DABIGATRAN, Cofact 250 IE poeder en oplosmiddel voor oplossing voor injectie., DALTEPARIN SODIUM, APIXABAN, ANDEXANET ALFA, Cofact 500 IE poeder en oplosmiddel voor oplossing voor injectie., DALTEPARIN SODIUM, ENOXAPARIN SODIUM, RIVAROXABAN, NADROPARIN CALCIUM, APIXABAN, NADROPARIN CALCIUM, ENOXAPARIN SODIUM, APIXABAN

Primary endpoint: Number of VTEs in the first 3 months postoperative, Number of major bleeds in the first 3 months postoperative.
Endpoint(s): Clinically relevant non major bleeding, Impact of events on QALY’s, Healthcare costs, Prosthetic joint infections, Patient reported outcome measures, Myocardial infarction, Ischemic stroke, Death

Source: https://euclinicaltrials.eu/ctis-public/view/2023-510186-98-00